EU clinical trial 2024-512799-36-00: A study to test whether different combinations of BI 765063, ezabenlimab, chemotherapy, cetuximab, and BI 836880 help people with head and neck cancer or liver cancer
Protocol code: 1443-0002
Sponsor: Boehringer Ingelheim International GmbH (Pharmaceutical company). Phase: Human Pharmacology (Phase I)- Other. Countries: France (ended), Romania (ended), Spain (ended).
Therapeutic area(s): Diseases [C] - Neoplasms [C04]
Gender: Female, Male. Age: 18-64 years, 65+ years. Enrolment: 21.
Status: Ended. Start date (EU): 2022-06-16. End date (EU): 2026-06-02. End date: 2026-06-22. Decision date: 2024-07-23. Results received: No. Last updated: 2026-06-05.
Decision dates by country: ES: 2024-07-23, FR: 2024-08-21, RO: 2024-07-29

Condition(s): hepatocellular carcinoma, head and neck squamous cell carcinoma (HNSCC)

Source: https://euclinicaltrials.eu/ctis-public/view/2024-512799-36-00